EU clinical trial 2023-506733-30-00: Daratumumab, pomalidomide and dexamethasone for del(17p) positive relapsed and relapsed/refractory multiple myeloma patients [DEDALO]
Protocol code: DEDALO
Sponsor: Fondazione European Myeloma Network Italy O.N.L.U.S. (Patient organisation/association). Phase: Therapeutic exploratory (Phase II). Countries: Italy (ongoing, recruitment ended).
Therapeutic area(s): Diseases [C] - Neoplasms [C04]
Gender: Female, Male. Age: 18-64 years, 65+ years. Enrolment: 45.
Status: Ongoing, recruitment ended. Start date (EU): 2019-05-16. Decision date: 2024-02-26. Results received: No. Last updated: 2026-04-09.
Decision dates by country: IT: 2024-04-22

Condition(s): Multiple Myeloma relapsed and/or refractory
Product: SOLDESAM 0,2% gocce orali, soluzione, DARZALEX 1800 mg solution for injection, Imnovid 3 mg hard capsules, SOLDESAM 8 mg/2 ml soluzione iniettabile, Imnovid 4 mg hard capsules, Imnovid 1 mg hard capsules, Imnovid 2 mg hard capsules

Primary endpoint: The primary endpoint of the study is efficacy in terms of: Achievement of molecular minimal residual disease (MRD) 10-5 negativity rate assessed by means of nextgeneration sequencing (ClonoSEQ assay) in patients attaining a complete remission in the first year of treatment.
Endpoint(s): PFS will be measured from the start of treatment to the date of first observation of disease progression or death to any cause as an event., Overall response rate (ORR)., Progression free survival 2 (PFS2)., Duration of response (DoR)., Overall survival (OS)., Safety., Time to the next anti-myeloma therapy (TNT)., Subgroup analyses: MRD negativity rate and prognostic factors.

Source: https://euclinicaltrials.eu/ctis-public/view/2023-506733-30-00